EU clinical trial 2024-514213-35-00: A Study to Assess the Safety, Pharmacokinetics, and Pharmacodynamics of AZD8630, Administered Once Daily via Inhalation, for 2 Weeks, in Adults with Asthma on Medium-to-high Dose Inhaled Corticosteroids and Long-acting Beta-agonists
Protocol code: D6830C00004
Sponsor: AstraZeneca AB (Pharmaceutical company). Phase: Human Pharmacology (Phase I)- Other. Countries: Germany (ended).
Therapeutic area(s): Diseases [C] - Respiratory Tract Diseases [C08]
Gender: Female, Male. Age: 18-64 years, 65+ years. Enrolment: 24.
Status: Ended. Start date (EU): 2025-01-20. End date (EU): 2025-06-27. Decision date: 2024-10-17. Results received: No. Last updated: 2025-04-01.

Condition(s): Asthma

Source: https://euclinicaltrials.eu/ctis-public/view/2024-514213-35-00